EU clinical trial 2025-524053-14-00: Phase 1 Single Ascending and Multiple Ascending Dose Study with LCA-0321
Protocol code: LCA-0321-01
Sponsor: Lycia Therapeutics Inc. (Pharmaceutical company). Phase: Human Pharmacology (Phase I)- First administration to humans. Countries: Netherlands (ongoing, recruiting).
Therapeutic area(s): Diseases [C] - Immune System Diseases [C20]
Gender: Female, Male. Age: 18-64 years, 65+ years. Enrolment: 48.
Status: Ongoing, recruiting. Start date (EU): 2026-04-02. Decision date: 2026-03-06. Results received: No. Last updated: 2026-06-29.

Condition(s): Graves Disease

Source: https://euclinicaltrials.eu/ctis-public/view/2025-524053-14-00